EU clinical trial 2025-523806-34-00: Double-T - Improving outcomes in high-risk 2nd line relapsed/refractory Large B-Cell Lymphoma patients eligible for CAR-T-cell therapy with a Glofitamab-based induction and consolidation concept
Protocol code: UKD-IKF-Double-T
Sponsor: Frankfurter Institut Fuer Klinische Krebsforschung IKF GmbH (Pharmaceutical company). Phase: Therapeutic exploratory (Phase II). Countries: Germany (authorised, recruiting).
Therapeutic area(s): Diseases [C] - Pathological Conditions, Signs and Symptoms [C23]; Diseases [C] - Neoplasms [C04]; Diseases [C] - Hemic and Lymphatic Diseases [C15]
Gender: Female, Male. Age: 18-64 years, 65+ years. Enrolment: 20.
Status: Authorised, recruiting. Start date (EU): 2026-07-06. Decision date: 2026-04-15. Results received: No. Last updated: 2026-04-15.

Condition(s): relapsed/refractory Large B-Cell Lymphoma
Product: Columvi 10 mg concentrate for solution for infusion, Gazyvaro 1,000 mg concentrate for solution for infusion., Breyanzi 1.1-70 × 106 cells/mL / 1.1-70 × 106 cells/mL dispersion for infusion, YESCARTA 0.4 – 2 x 10e8 cells dispersion for infusion

Primary endpoint: Complete response rate (CRR) at end of treatment (CCR@EOT), defined as proportion of patients who achieved complete response at the end of trial treatment as per Lugano classification
Endpoint(s): CRR post induction treatment (CCR@pIT) and at 3 months post-CAR-T cell infusion (CRR@3MpCT), Overall CRR, Objective Response rate (ORR) after induction treatment (ORR@pIT), at 3 months post-CAR-T cell infusion (ORR@3MpCT) and at the end of trial treatment (ORR@EOT), Overall ORR, Best overall response rate (BORR), Progression-free survival (PFS) plus PFS rate at one and two years after start of trial treatment, Overall survival (OS) plus OS rate at one and two years after start of trial treatment, Quantification of peak CAR-T cell expansion in peripheral blood following Glofitamab consolidation (measured by flow cytometry and/or qPCR for CAR transgene), Time to peak CAR-T cell expansion post-infusion, Duration of CAR-T cell persistence in peripheral blood (up to end of evaluation period or loss of detectability), Correlation between CAR-T cell expansion/persistence and clinical response (e.g., CR, PR, PFS), Assessment of safety of the treatment as determined by the incidence, type, causality, frequency, timing, severity and seriousness of adverse events using NCI CTCAE 6.0, Incidence of AEs of special Interest (AESIs) as listed in the protocol, Tolerability as determined by proportion of patients completing all planned cycles, Quality of life over time as determined by EORTC QLQ-C30 questionnaire

Source: https://euclinicaltrials.eu/ctis-public/view/2025-523806-34-00